EU clinical trial 2024-514058-59-00: A phase 2 open label study of caBozantinib in patients with advanced or unresectable Renal cEll cArcinoma pretreated with one immunochecKPOint INhibiTor (anti PD1/PDL1).
Protocol code: BREAKPOINT
Sponsor: Fondazione IRCCS Istituto Nazionale Dei Tumori (Hospital/Clinic/Other health care facility). Phase: Therapeutic exploratory (Phase II). Countries: Italy (ongoing, recruitment ended).
Therapeutic area(s): Diseases [C] - Neoplasms [C04]
Gender: Female, Male. Age: 18-64 years, 65+ years. Enrolment: 49.
Status: Ongoing, recruitment ended. Start date (EU): 2018-06-11. Decision date: 2024-07-29. Results received: No. Last updated: 2025-12-01.

Condition(s): Patients with metastatic clear cell renal cell carcinoma pretreated with immunocheckpoints inhibitors.
Product: CABOZANTINIB

Primary endpoint: Progression Free Survival (PFS)
Endpoint(s): Overall Survival (OS), Objective Response Rates (ORR), Safety profile of the drug

Source: https://euclinicaltrials.eu/ctis-public/view/2024-514058-59-00